EU clinical trial 2025-522528-29-00: The effect of colchicine, on insulin sensitivity in individuals with type 1 diabetes and systemic low-grade inflammation (INS1GHT)
Sponsor: Gentofte Hospital (Hospital/Clinic/Other health care facility). Phase: Therapeutic exploratory (Phase II). Countries: Denmark (ongoing, recruiting).
Therapeutic area(s): Diseases [C] - Hormonal diseases [C19]; Diseases [C] - Nutritional and Metabolic Diseases [C18]
Gender: Female, Male. Age: 18-64 years, 65+ years. Enrolment: 26.
Status: Ongoing, recruiting. Start date (EU): 2025-12-22. Decision date: 2025-09-26. Results received: No. Last updated: 2025-09-26.

Condition(s): Type 1 diabetes
Product: COLCHICINE, The placebo tablets are visually identical to colchicine tablets and consist of Potato starch and Lactose monohydrate

Primary endpoint: Change in M-value after four weeks of placebo/colchicine
Endpoint(s): Mean difference in M-value (adjusted to body surface area (BSA), Mean difference in M-value (adjusted to fat free mass), Mean difference in Insulin Sensitivity Index (ISI), Mean difference in average daily insulin dosage, Fold difference in Insulin sensitivity by estimated glucose disposal rate (eGDR), Fold difference in in fasting serum/plasma concentrations of inflammation markers hsCRP, IL-6, Tumour necrosis factor α

Source: https://euclinicaltrials.eu/ctis-public/view/2025-522528-29-00